EU clinical trial 2023-505356-22-00: Phase II study evaluating Holmium-166 TARE followed by maIntenance Therapy in liver limited unresectable colorectal cancer patients after first-lIne chemotherapy and target agents: The HAITI study.
Protocol code: HAITI
Sponsor: Gruppo Oncologico Del Nord Ovest (Patient organisation/association). Phase: Therapeutic exploratory (Phase II). Countries: Italy (ended).
Therapeutic area(s): Diseases [C] - Neoplasms [C04]
Gender: Female, Male. Age: 18-64 years, 65+ years. Enrolment: 46.
Status: Ended. Start date (EU): 2024-03-13. End date (EU): 2025-11-14. Decision date: 2023-12-18. Results received: No. Last updated: 2023-12-18.

Condition(s): Liver limited unresectable colorectal cancer
Product: CAPECITABINE, BEVACIZUMAB, PANITUMUMAB, CETUXIMAB, FLUOROURACIL, CALCIUM LEVOFOLINATE

Primary endpoint: Progression-free survival (PFS) Rate at 9- and 8-months for Cohort A and B, respectively
Endpoint(s): Overall Toxicity rate, G3/4 Toxicity rate, Post-treatment DCR, Progression free survival (PFS), Overall Survival (OS), Dose-response relationships, Quality of Life

Source: https://euclinicaltrials.eu/ctis-public/view/2023-505356-22-00